EU clinical trial 2025-522965-31-00: C6231002 - A PHASE 2B, RANDOMIZED, DOUBLE-BLIND, PLACEBO-CONTROLLED, DOSE RANGING STUDY TO EVALUATE THE EFFICACY AND SAFETY OF PF 08049820 IN ADULT PARTICIPANTS WITH MODERATE TO SEVERE ATOPIC DERMATITIS
Protocol code: C6231002
Sponsor: Pfizer Inc. (Pharmaceutical company). Phase: Therapeutic exploratory (Phase II). Countries: Poland (authorised, recruitment pending), Czechia (authorised, recruitment pending), Germany (authorised, recruitment pending), Bulgaria (authorised, recruitment pending), France (authorised, recruitment pending).
Therapeutic area(s): Diseases [C] - Skin and Connective Tissue Diseases [C17]
Gender: Female, Male. Age: 18-64 years. Enrolment: 49.
Status: Authorised, recruitment pending. Decision date: 2026-04-14. Results received: No. Last updated: 2026-04-20.
Decision dates by country: BG: 2026-04-20, CZ: 2026-04-14, FR: 2026-04-16, DE: 2026-04-14, PL: 2026-04-20

Condition(s): Atopic Dermatitis
Product: PF-08049820, PF-08049820, Placebo for PF-08049820

Primary endpoint: Percent change from baseline in EASI total score at Week 12
Endpoint(s): Response based on achieving EASI75 (≥75% improvement from baseline) at scheduled time points, Percent change from baseline in EASI total score at scheduled time points other than Week 12, Response based on achieving vIGA score of clear (0) or almost clear (1) (on a 5-point scale) and a reduction from baseline of ≥2 points at scheduled time points, Response based on achieving ≥4 points of reduction from baseline in weekly averages of Peak Pruritus Numerical Rating Scale (PP-NRS4) at scheduled time points, Incidence of treatment emergent adverse events (AEs), serious adverse events (SAEs), and clinically significant changes in laboratory tests, vital signs, and electrocardiograms (ECGs)

Source: https://euclinicaltrials.eu/ctis-public/view/2025-522965-31-00